EU clinical trial 2023-504928-26-00: A Phase 3, Randomized, Double-blind, Placebo-controlled, Parallel-group Study to Evaluate the Efficacy and Safety of Erenumab in Children (6 to < 12 Years) and Adolescents (12 to < 18 Years) With Chronic Migraine (OASIS PEDIATRIC [CM])
Protocol code: 20160354
Sponsor: Amgen Inc. (Pharmaceutical company). Phase: Therapeutic confirmatory (Phase III). Countries: Italy (ended), Germany (ended), Hungary (ended), Poland (ended), Belgium (ended).
Therapeutic area(s): Diseases [C] - Nervous System Diseases [C10]
Gender: Female, Male. Age: 0-17 years. Enrolment: 101.
Status: Ended. Start date (EU): 2019-07-19. End date (EU): 2026-01-06. End date: 2026-01-07. Decision date: 2024-07-17. Results received: Yes. Last updated: 2025-10-13.
Decision dates by country: PL: 2024-08-04, IT: 2024-09-04, BE: 2024-07-18, DE: 2024-07-22, HU: 2024-07-17

Condition(s): Chronic Migraine
Product: Placebo for AMG 334, Erenumab

Primary endpoint: Change from baseline in MMD to week 9 through week 12 (month 3) of the DBTP., The target population, which is the adolescent subjects (12 to < 18 years of age) diagnosed with CM., The primary endpoint, which is the change in MMD from baseline to week 9 through week 12 (month 3) of the DBTP., The summary measure, which is the difference between the mean of the primary endpoint for the combined erenumab dose group and placebo., The intercurrent event is treatment discontinuation. The treatment effect will be estimated for all randomized subjects regardless of adherence to treatment.
Endpoint(s): Change from baseline in monthly headache days to week 9 through week 12 (month 3) of the DBTP., Achievement of at least 50% reduction in MMD from baseline to week 9 through week 12 (month 3) of the DBTP., Change from baseline in MMD to the average of the first 3 months (week 1 through week 12) of the DBTP., Change from baseline in monthly average severity of migraine attacks to week 9 through week 12 (month 3) of the DBTP., Change from baseline in migraine-related disability and productivity as measured by the modified PedMIDAS to (month 3) of the DBTP

Source: https://euclinicaltrials.eu/ctis-public/view/2023-504928-26-00